EU clinical trial 2024-517448-79-00: Spironolactone Initiation Registry Randomized Interventional Trial in Heart Failure with Preserved Ejection Fraction SPIRRIT-HFpEF
Sponsor: Region Uppsala (Hospital/Clinic/Other health care facility). Phase: Therapeutic confirmatory (Phase III). Countries: Sweden (ongoing, recruitment ended).
Therapeutic area(s): Diseases [C] - Cardiovascular Diseases [C14]
Gender: Female, Male. Age: 18-64 years, 65+ years. Enrolment: 2000.
Status: Ongoing, recruitment ended. Start date (EU): 2017-11-23. Decision date: 2024-09-23. Results received: No. Last updated: 2026-03-31.

Condition(s): Heart failure with preserved ejection fraction
Product: SPIRONOLACTONE, EPLERENONE

Primary endpoint: Incidence rate for total heart failure (HF) hospitalizations or cardiovascular (CV) death.
Endpoint(s): Time to CV death or first HF hospitalization, Time to CV death, Incidence rate for total HF hospitalizations, Time to HF hospitalization, Time to all-cause mortality, Incidence rate for total all-cause hospitalizations, Time to all-cause hospitalization, Incidence rate for all-cause hospitalization or all-cause mortality

Source: https://euclinicaltrials.eu/ctis-public/view/2024-517448-79-00